EU clinical trial 2022-503011-42-00: Treatment of Chronic Hand Eczema with Oral Roflumilast (HERO) – a randomized controlled trial
Sponsor: Bispebjerg Hospital (Hospital/Clinic/Other health care facility). Phase: Therapeutic exploratory (Phase II). Countries: Denmark (ended).
Therapeutic area(s): Diseases [C] - Skin and Connective Tissue Diseases [C17]
Gender: Female, Male. Age: 18-64 years, 65+ years. Enrolment: 40.
Status: Ended. Start date (EU): 2023-09-25. End date (EU): 2025-06-17. Decision date: 2023-03-20. Results received: No. Last updated: 2023-03-20.

Condition(s): Chronic hand eczema
Product: ROFLUMILAST, PLACEBO

Primary endpoint: Proportion of patients achieving at least 75% reduction in hand eczema severity index (HECSI75) at week 16 when compared to HECSI at baseline. HECSI is a measure of hand eczema disease severity considering the extent and intensity of the disease. The score reflects HE severity as following: 1-16, mild HE; 17-37, moderate HE; 38-116 severe HE and 117-360, very severe HE.
Endpoint(s): Proportion of patients achieving at least 50% reduction in baseline HECSI (HECSI50) at assessments, Proportion of patients achieving at least 90% reduction in baseline HECSI (HECSI90) at assessments, Proportion of patients achieving at least 100% reduction in baseline HECSI (HECSI100) at assessments, Percent change from baseline in HECSI score at assessments, Change (2 or more points) in physician global assessment for chronic hand eczema IGA-CHE) at assessments. The IGA-CHE rates the severity of the patient’s global disease assessed by the physician and is based on a 5-point scale ranging from 0 (clear) to 4 (severe), Change from baseline in quality of life hand eczema questionnaire (QOLHEQ) at assessments. QOLHEQ is a validated, self-administered 30-question questionnaire that measures impairment of health-related quality of life (HRQoL) in patients with HE. . Each question is answered on a scale of 0 (not at all) to 4 (all the time) and the total score may vary from 0 to 120. A QOLHEQ score greater than 86 is indicative of very strong impairment., Change from baseline in dermatology life quality index (DLQI) at assessments. DLQI is a validated, self-administered, 10-item questionnaire that measure the impact of skin disease on patients’ quality of life, based on recall over the past week. Domains include symptoms, feeling, daily activities, social, leisure, work or studying, personal relationships, and treatment. Each question is answered on a scale of 0 (not at all) to 3 (very much) and the total score may vary from 0 to 30., Change from baseline in patient’s global assessment (PaGA) at assessments. The PaGA rates the severity of the patient’s global disease assessed by the patient and is based on a 5-point scale ranging from 0 (clear) to 4 (severe)., Change from baseline in numeric rating scale (NRS) – Peak skin pain on hands within the last 24 hours and 7 days at assessments. NRS is a simple and commonly used numeric scale in which the patient rates patientive symptoms such as pain, itch and sleeplessness on a scale from 0 (no pain, no itch, no sleeplessness) to 10 (worst pain, worst itch, worst sleeplessness)., Change from baseline in NRS – Peak itch on hands within the last 24 hours and 7 days at assessments., Change from baseline in NRS – sleeplessness within the last 24 hours and 7 days at assessments., Change from baseline in NRS – patient treatment satisfaction within the last 7 days at assessments., Change from baseline in work productivity and activity impairment: CHE (WPAI:CHE) at assessments. WPAI is a validated, self-administered questionnaire that measures the impact of CHE on work. Domains include time missed from work and impairment of work and regular activities due to CHE., Adverse events (AEs), serious adverse events (SAEs), serious adverse reactions (SARs), and suspected unexpected serious adverse reactions (SUSARS) documented at assessments.

Source: https://euclinicaltrials.eu/ctis-public/view/2022-503011-42-00